EU clinical trial 2023-504713-76-00: A Phase 3, Open-label, Efficacy-Assessor-Blinded Study, Comparing the Safety and Efficacy of Upadacitinib to Dupilumab in Children from 2 to Less than 12 Years of Age with Moderate to Severe Atopic Dermatitis (START UP)
Protocol code: M17-380
Sponsor: AbbVie Deutschland GmbH & Co. KG (Pharmaceutical company). Phase: Therapeutic confirmatory (Phase III). Countries: Slovakia (ongoing, recruiting), Austria (ongoing, recruiting), France (ongoing, recruiting), Portugal (ongoing, recruiting), Croatia (ongoing, recruiting), Bulgaria (ended), Spain (ongoing, recruiting), Germany (ongoing, recruiting), Italy (ongoing, recruiting), Poland (ongoing, recruiting), Netherlands (ongoing, recruiting), Hungary (ongoing, recruiting).
Therapeutic area(s): Diseases [C] - Immune System Diseases [C20]
Gender: Female, Male. Age: 0-17 years. Enrolment: 260.
Start date (EU): 2024-12-03. Decision date: 2024-10-22. Results received: No. Last updated: 2026-08-05.
Decision dates by country: BG: 2024-10-28, IT: 2024-10-25, NL: 2024-10-23, ES: 2024-10-22, FR: 2024-10-22, PT: 2024-10-25, AT: 2024-10-23, DE: 2024-10-24, HR: 2024-10-28, HU: 2024-10-24, SK: 2024-10-22, PL: 2024-12-11

Condition(s): Dermatitis atopic
Product: DUPILUMAB, Upadacitinib, Upadacitinib, DUPILUMAB, Upadacitinib, Upadacitinib, Upadacitinib

Primary endpoint: Percentage of Participants Achieving a 75% Reduction in Eczema Area and Severity Index Score (EASI 75) at Week 16 (other than US), Achievement of validated Investigator Global Assessment scale for Atopic Dermatitis (vIGA-AD) 0 or 1 with a reduction from Baseline of ≥ 2 points at Week 16 (US and China only, descriptive)
Endpoint(s): Percentage of participants achieving validated Investigator Global Assessment for Atopic Dermatitis (vIGA-AD) of 0 or 1 (on a 5-point scale) with a reduction from Baseline of ≥ 2 Points at Week 16 (other than US and China), Percentage of participants achieving a 50% reduction from Baseline in EASI score (EASI 50) at Week 16, Percentage of participants achieving Investigator Global Assessment for Atopic Dermatitis (vIGA-AD) of 0 or 1 (on a 5-point scale) with a reduction from Baseline of ≥ 2 Points at Week 52, Percentage of participants achieving Investigator Global Assessment for Atopic Dermatitis (vIGA-AD) of 0 or 1 (on a 5-point scale) with a reduction from Baseline of ≥ 2 Points at Week 160, Percentage of participants achieving an improved (reduced) Patient Oriented Eczema Measure (POEM) of ≥ 4 points at Week 16 from participants with POEM ≥ 4 at Baseline, Percentage of for participants ≥ 4 years of age with a Baseline Children's Dermatology Life Quality Index (CDLQI) score of >1 participants achieving a CDLQI score of 0 or 1 at Week 8, Percentage of for participants ≥ 4 years of age with a Baseline Children's Dermatology Life Quality Index (CDLQI) score of >1 participants achieving a CDLQI score of 0 or 1 at Week 16, Percent change in Scoring Atopic Dermatitis (SCORAD) from Baseline at Week 16, Use of topical or systemic rescue therapy from Baseline to Week 16, Number of days on rescue topical corticosteroid or topical calcineurin inhibitor from Baseline to Week 16, Percentage of participants achieving a EASI 75 response at Week 16 for low dose Dupilumab daily adult equivalent dose, Achievement of EASI 75 response at Week 16 (US)

Source: https://euclinicaltrials.eu/ctis-public/view/2023-504713-76-00